EU clinical trial 2023-503271-24-01: Safety and efficacy of mitapivat sulfate in adult patients with erythrocyte membranopathies
Protocol code: SATISFY
Sponsor: Eurobloodnet Association (Patient organisation/association). Phase: Therapeutic exploratory (Phase II). Countries: Denmark (ongoing, recruiting), Netherlands (ongoing, recruiting).
Therapeutic area(s): Diseases [C] - Hemic and Lymphatic Diseases [C15]
Gender: Female, Male. Age: 18-64 years, 65+ years. Enrolment: 24.
Status: Ongoing, recruiting. Start date (EU): 2023-12-29. Decision date: 2023-12-04. Results received: No. Last updated: 2026-05-28.
Decision dates by country: DK: 2023-12-04, NL: 2023-12-07

Condition(s): erythrocyte membranopathies
Product: Pyrukynd 20 mg film-coated tablets, Pyrukynd 50 mg film-coated tablets, Pyrukynd 5 mg film-coated tablets, MITAPIVAT

Primary endpoint: Safety of mitapivat in the study population is the main endpoint in this study. The overall safety profile of study drug will be assessed in terms of the following safety and tolerability endpoints:, - Incidence of treatment-emergent adverse events (TEAEs), - Clinical laboratory values, - ECGs (standard 12-lead), - Physical examination findings, - DEXA scans, - Type, incidence, severity and relationship of mitapivat to AE and SAE
Endpoint(s): Hb response (HR) defined as a ≥1 g/dL increase in Hb concentration from baseline (mean of Screening and D0) that is sustained at 2 or more points during fixed dose period 1., Change from baseline in Hb levels to the average of scheduled visits in fixed dose period 2., Average change in mean Hb concentration during Fixed Dose Periods 1 and 2 compared to baseline (mean of Screening and D0), Proportion of subjects who achieve Hb concentration in the sex-associated normal range that is sustained at two or more points in the fixed dose periods 1 and 2, Change from baseline in lactate dehydrogenase (LDH), bilirubin, and haptoglobin at the end of fixed dose period 1 and 2., Change from baseline in reticulocytes erythropoietin, erythroferrone, and sTfR at the end of fixed dose period 1 and 2., Change from baseline in in fixed dose periods 1 and 2: • Health related Quality of Life (HRQoL) (SF-36 version 1) • Pyruvate Kinase Deficiency Impact Asessment (PKDIA), Change from baseline in spleen volume in fixed dose periods 1 and 2

Source: https://euclinicaltrials.eu/ctis-public/view/2023-503271-24-01